EU clinical trial 2025-523941-81-00: A Randomized, Double-blind, Parallel-group Phase III Study to Evaluate the Efficacy, Safety, and Tolerability of Elecoglipron and Dapagliflozin in Combination, Compared with Elecoglipron Alone and Dapagliflozin Alone, in Adults with Type 2 Diabetes Mellitus (Eluminate-5)
Protocol code: D7261C00003
Sponsor: AstraZeneca AB (Pharmaceutical company). Phase: Therapeutic confirmatory (Phase III). Countries: Slovakia (authorised, recruitment pending), Czechia (authorised, recruitment pending), Germany (authorised, recruitment pending), Greece (authorised, recruitment pending), Denmark (authorised, recruitment pending).
Therapeutic area(s): Diseases [C] - Nutritional and Metabolic Diseases [C18]
Gender: Female, Male. Age: 18-64 years, 65+ years. Enrolment: 240.
Status: Authorised, recruitment pending. Decision date: 2026-08-03. Results received: No. Last updated: 2026-08-06.
Decision dates by country: CZ: 2026-08-05, DK: 2026-08-03, DE: 2026-08-04, GR: 2026-08-04, SK: 2026-08-06

Condition(s): type 2 diabetes mellitus
Product: Elecoglipron, Placebo for Elecoglipron (AZD5004), Elecoglipron, Forxiga 10 mg film-coated tablets, Elecoglipron, Elecoglipron, Placebo for Forxiga

Primary endpoint: Change from baseline to Week 40 in HbA1c (%)
Endpoint(s): Change from baseline to Week 40 in HbA1c (%), Achieved HbA1c < 7% (53 mmol/mol) at Week 40 - Percent change from baseline to Week 40 in body weight - Change from baseline to Week 40 in body weight (kg), Change from baseline to Week 40 in HbA1c (%) - Percent change from baseline to Week 40 in body weight, Change from baseline to Week 40 in HbA1c (%) - Achieved HbA1c < 7% (53 mmol/mol) at Week 40 - Percent change from baseline to Week 40 in body weight - Change from baseline to Week 40 in body weight (kg), Change from baseline to Week 40 in FPG - Change from baseline to Week 40 in daily mean 7-point SMBG - Achieved ≥ 5% weight loss from baseline at Week 40 - Change from baseline to Week 40 in SBP and DBP - Time to initiation of rescue medication over 40 weeks, Change from baseline to Week 40 in FPG - Change from baseline to Week 40 in daily mean 7-point SMBG - Achieved ≥ 5% weight loss from baseline at Week 40 - Change from baseline to Week 40 in SBP and DBP - Time to initiation of rescue medication over 40 weeks, Change from baseline to Week 40 in FPG - Change from baseline to Week 40 in daily mean 7-point SMBG - Achieved ≥ 5% weight loss from baseline at Week 40 - Change from baseline to Week 40 in SBP and DBP - Time to initiation of rescue medication over 40 weeks

Source: https://euclinicaltrials.eu/ctis-public/view/2025-523941-81-00